EU clinical trial 2023-507306-13-00: A Multicenter, Open-Label, Single-Arm, Phase II Trial Exploring the Maintenance of Trastuzumab and Pertuzumab Following Trastuzumab Deruxtecan as Induction Treatment for HER2-positive Unresectable Locally Advanced or Metastatic Breast Cancer Patients (The DEMETHER Study)
Protocol code: MEDOPP562
Sponsor: Medica Scientia Innovation Research S.L. (Pharmaceutical company). Phase: Therapeutic exploratory (Phase II). Countries: Spain (ongoing, recruitment ended), France (ongoing, recruitment ended), Germany (ongoing, recruitment ended), Italy (ongoing, recruitment ended).
Therapeutic area(s): Diseases [C] - Neoplasms [C04]
Gender: Female, Male. Age: 18-64 years, 65+ years. Enrolment: 132.
Status: Ongoing, recruitment ended. Start date (EU): 2025-04-13. Decision date: 2024-05-17. Results received: No. Last updated: 2026-04-08.
Decision dates by country: DE: 2024-05-22, FR: 2024-05-17, IT: 2024-05-21, ES: 2024-05-17

Condition(s): HER2-positive unresectable locally recurrent or metastatic breast cancer (MBC).
Product: Phesgo 600 mg/600 mg solution for injection, Phesgo 1200 mg/600 mg solution for injection, Enhertu 100 mg powder for concentrate for solution for infusion

Primary endpoint: 1-year PFS rate, defined as the rate of participants with absence of disease progression or death from any cause 1 year after t treatment initiation, as determined locally by the investigator using RECIST v.1.1 criteria., 3-year OS rate, defined as the rate of participants alive 3 years after treatment initiation, as determined locally by the investigator.
Endpoint(s): PFS, defined as the period from treatment initiation to the first occurrence of disease progression or death from any cause, whichever occurs first, as determined locally by the investigator using RECIST v.1.1., OS, defined as the period from treatment initiation to death from any cause, as determined locally by the investigator., ORR, defined as the rate of participants with complete response (CR) or partial response (PR), as determined locally by the investigator using RECIST v.1.1., CBR, defined as the rate of participants with objective response (CR or PR), or stable disease for at least 24 weeks, as determined locally by the investigator using RECIST v.1.1., TTR, defined as the period from treatment initiation to the first objective tumor response (tumor shrinkage of ≥ 30%) observed for participants who achieved a CR or PR, as determined locally by the investigator using RECIST v.1.1., DoR, defined as the period from the first occurrence of a documented objective response to disease progression or death from any cause, whichever occurs first, as determined locally by the investigator using RECIST v.1.1., Best percentage of change from baseline in the size of target tumor lesions, defined as the biggest decrease, or smallest increase if no decrease will be observed, as determined locally by the investigator using RECIST v.1.1., Safety endpoints: Changes from baseline in the EORTC QLQ-C30, the EORTC QLQ-BR45, and the EQ-5D-5L scales and symptoms scores., Safety endpoints: Safety and tolerability as per NCI-CTCAE v.5.0., Exploratory endpoints: Association of prognostic and/or predictive biomarkers in tumor tissue and/or liquid biopsy with PFS, OS, ORR, CBR, TTR, DoR, and maximum tumor reduction., Exploratory endpoints: Efficacy endpoints for all participants according to different clinicopathological characteristics and prior treatment for early breast cancer., Exploratory endpoints: Association of treatment efficacy outcomes in all participants with radiological imaging biomarkers.

Source: https://euclinicaltrials.eu/ctis-public/view/2023-507306-13-00